EU clinical trial 2023-506540-16-01: A Phase 2 Long-Term Open-Label Trial to Assess the Safety and Efficacy of Repeat Dosing of STAR-0215 in Adult Patients with Hereditary Angioedema (The ALPHA-SOLAR Trial)
Protocol code: STAR-0215-202
Sponsor: Astria Therapeutics Inc. (Pharmaceutical company). Phase: Therapeutic exploratory (Phase II). Countries: Poland (ongoing, recruitment ended), Germany (ongoing, recruitment ended), Bulgaria (ongoing, recruitment ended), Czechia (ongoing, recruitment ended).
Therapeutic area(s): Diseases [C] - Congenital, Hereditary, and Neonatal Diseases and Abnormalities [C16]
Gender: Female, Male. Age: 18-64 years, 65+ years. Enrolment: 26.
Status: Ongoing, recruitment ended. Start date (EU): 2025-01-20. Decision date: 2024-11-15. Results received: No. Last updated: 2026-07-15.
Decision dates by country: CZ: 2024-11-15, PL: 2024-11-18, BG: 2024-11-18, DE: 2024-11-18

Condition(s): Hereditary Angioedema
Product: Navenibart

Primary endpoint: Incidence of adverse events (AEs)
Endpoint(s): Change from baseline in monthly HAE attack rate, Incidence of monthly HAE attack severity (mild, moderate, and severe), Duration of monthly HAE attack (shorter than 12 hours, 12 to 24 hours, 24 to 48 hours, and longer than 48 hours), The number of monthly HAE attacks requiring on-demand therapy, Time to first HAE attack after each dose, Number of HAE attack-free days, Proportion of HAE attack-free participants (i.e., participants having 0 HAE attacks during the specified treatment period), Concentration of STAR-0215 and the derived PK parameters, Change in plasma kallikrein activity, Formation of anti-drug (STAR-0215) antibodies

Source: https://euclinicaltrials.eu/ctis-public/view/2023-506540-16-01